EU clinical trial 2023-507421-41-00: A Phase I study of IDH305 in patients with advanced malignancies that harbor IDH1R132 mutations
Protocol code: CIDH305X2101
Sponsor: Novartis Pharma AG (Pharmaceutical company). Phase: Human Pharmacology (Phase I)- First administration to humans. Countries: Germany (ongoing, recruitment ended).
Therapeutic area(s): Diseases [C] - Neoplasms [C04]
Gender: Female, Male. Age: 18-64 years. Enrolment: 2.
Status: Ongoing, recruitment ended. Start date (EU): 2015-07-20. Decision date: 2024-03-14. Results received: No. Last updated: 2025-11-27.

Condition(s): Advanced malignancies that harbor IDH1R132 mutations

Source: https://euclinicaltrials.eu/ctis-public/view/2023-507421-41-00